EU clinical trial 2024-518192-61-00: Neoadjuvant trastuzumab, pertuzumab and tucatinib without chemotherapy in HER2-positive breast cancer: the TRAIN-4 study
Protocol code: N21TRV
Sponsor: Het Nederlands Kanker Instituut-Antoni van Leeuwenhoek Ziekenhuis Stichting (Hospital/Clinic/Other health care facility). Phase: Phase I and Phase II (Integrated)- Other. Countries: Netherlands (ongoing, recruiting).
Therapeutic area(s): Diseases [C] - Neoplasms [C04]
Gender: Female, Male. Age: 18-64 years, 65+ years. Enrolment: 30.
Status: Ongoing, recruiting. Start date (EU): 2023-12-08. Decision date: 2024-11-12. Results received: No. Last updated: 2025-05-08.

Condition(s): Breast cancer
Product: TUCATINIB, Herceptin 150 mg powder for concentrate for solution for infusion, Perjeta 420 mg concentrate for solution for infusion

Primary endpoint: Incidence and severity of adverse events (all grades) until 30 days after last study treatment administration
Endpoint(s): Incidence of serious adverse events until 30 days after last study treatment administration, Incidence of progressive disease during neoadjuvant treatment -progressive disease: defined as 20% increase ΔFTV or >20% increase measured in the longest diameter on DCE-MRI or unequivocal new lesions on (18)F-FDG PET, Incidence of dose reductions and treatment discontinuations, Radiologic complete response defined as the absence of pathologic enhancement on contrast enhanced MRI breast, Pathological complete response (ypT0/is N0) at surgery in patients treated without chemotherapy, and overall, Residual Cancer burden (RCB, 0-III) at surgery in patients treated without chemotherapy, and overall, Event-free survival (EFS) defined as the interval from registration to disease progression resulting in inoperability, recurrence, or death from any cause, whichever comes first at 3, 5 and 10 years after registration, Overall survival (OS) defined as the time from registration to death from any cause at 3, 5 and 10 years after registration

Source: https://euclinicaltrials.eu/ctis-public/view/2024-518192-61-00